EU clinical trial 2026-525343-33-00: A randomized, double blind, placebo-controlled, phase II, multicentre trial to explore the efficacy and safety of oral AP1189 tablets administered at the dose 100 mg/day for 12 weeks in patients diagnosed with polymyalgia rheumatica and in remission on glucocorticoid
Protocol code: SynAct-CS010
Sponsor: Synact Pharma ApS (Pharmaceutical company). Phase: Therapeutic exploratory (Phase II). Countries: Denmark (authorised, recruitment pending).
Therapeutic area(s): Diseases [C] - Musculoskeletal Diseases [C05]
Gender: Female, Male. Age: 18-64 years, 65+ years. Enrolment: 60.
Status: Authorised, recruitment pending. Decision date: 2026-03-19. Results received: No. Last updated: 2026-03-19.

Condition(s): Polymyalgia rheumatica
Product: Apart from the AP1189 granulate, the placebo tablet and AP1189 tablet are identical., AP1189 Tablet

Primary endpoint: Safety evaluations include adverse event monitoring, physical examinations, vital sign measurements, and clinical laboratory testing.
Endpoint(s): To investigate the effect of 100 mg/day AP1189 tablets against placebo tablets by evaluating the proportion of patients in glucocorticoid free remission at week, To investigate the effects of 100 mg/day AP1189 tablets against placebo tablets by evaluating: • Accumulated glucocorticoid dosage from baseline to week 12. • Time to first relapse from baseline to week 12. • Glucocorticoid free remission at week 12 (Remission defined as PMR-AS<10)., To investigate the effects of 100 mg/day AP1189 tablets against placebo tablets by evaluating: PMR activity score at week 4, 8, and 12 with the change from baseline to week 12 being of primary interest., To investigate the effects of 100 mg/day AP1189 tablets against placebo tablets by evaluating: Patient global VAS at week 4, 8, and 12 with the change from baseline to week 12 being of primary interest, To investigate the effects of 100 mg/day AP1189 tablets against placebo tablets by evaluating: SF-36 MCS at week 4, 8, and 12 with the change from baseline to week 12 being of primary interest, To investigate the effects of 100 mg/day AP1189 tablets against placebo tablets by evaluating: SF-36 PCS at week 4, 8, and 12 with the change from baseline to week 12 being of primary interest, To investigate the effects of 100 mg/day AP1189 tablets against placebo tablets by evaluating: HAQ-DI at week 4, 8, and 12 with the change from baseline to week 12 being of primary in-terest., To investigate the effects of 100 mg/day AP1189 tablets against placebo tablets by evaluating: Patient reported PMR VAS at week 4, 8, and 12 with the change from baseline to week 12 being of primary interest, To investigate the effects of 100 mg/day AP1189 tablets against placebo tablets by evaluating: Patient reported global VAS at week 4, 8, and 12 with the change from baseline to week 12 being of primary interest., To investigate the effects of 100 mg/day AP1189 tablets against placebo tablets by evaluating: Patient reported fatigue VAS at week 4, 8, and 12 with the change from baseline to week 12 being of primary interest, To investigate the effects of 100 mg/day AP1189 tablets against placebo tablets by evaluating: Patient reported morning stiffness VAS at week 4, 8, and 12 with the change from baseline to week 12 being of primary interest., To investigate the effects of 100 mg/day AP1189 tablets against placebo tablets by evaluating: Patient reported duration of morning stiffness at week 4, 8, and 12 with the change from baseline to week 12 being of primary interest

Source: https://euclinicaltrials.eu/ctis-public/view/2026-525343-33-00